EU clinical trial 2024-517264-27-00: A Double-blind, Placebo-controlled, Randomized Study to Evaluate the Efficacy and Safety of KBP-336 as an Adjunct to Diet and Exercise in Obese Individuals with Osteoarthritis of the Knee
Protocol code: KBP-336-CD-003
Sponsor: KeyBioscience S.A. (Pharmaceutical company). Phase: Therapeutic exploratory (Phase II). Countries: Denmark (ended), Czechia (ended), Romania (ended), Poland (ended).
Therapeutic area(s): Diseases [C] - Nutritional and Metabolic Diseases [C18]; Diseases [C] - Musculoskeletal Diseases [C05]
Gender: Female, Male. Age: 18-64 years, 65+ years. Enrolment: 495.
Status: Ended. Start date (EU): 2024-12-13. End date (EU): 2026-07-07. End date: 2026-07-09. Decision date: 2024-12-03. Results received: No. Last updated: 2026-06-23.
Decision dates by country: RO: 2025-05-06, PL: 2025-05-04, CZ: 2025-04-30, DK: 2024-12-03

Condition(s): Obesity, Knee osteoarthritis
Product: KBP-336, Matching Placebo, Panodil, filmovertrukne tabletter 500 mg (Ny formulering)

Primary endpoint: The proportional change from baseline in body weight at Day 183, OR The change from baseline in the WOMAC pain scale at Day 183
Endpoint(s): Change from baseline in WOMAC pain scale during the trial, Change from baseline in WOMAC total score, WOMAC stiffness and WOMAC function scales during the trial and at Day 183, Proportion of subjects reaching ≥5, ≥10 or ≥15% weight loss from baseline at Day 183., Proportion of subjects reaching ≥30 and ≥50% reduction in WOMAC pain scale from baseline at Day 183., Change from baseline in AQol 8D at Day 183, Change from baseline in AQol 8D subscore Independent living at Day 183, Change from baseline in the weekly average of daily pain during the trial, and at Day 183, Area under the curve from baseline in the weekly average of daily pain to Day 183, Change from baseline to Day 183 in waist-to-hip ratio, Change from baseline in whole body composition by DXA at Day 183, Change from baseline in bone mineral density of the lumber spine, femoral head, and total hip by DXA at Day 183, Change from baseline in PGA at Day 183, OMERACT-OARSI responder rates at Day 183, Average weekly days using rescue medication, Change from baseline in ICOAP at Day 183

Source: https://euclinicaltrials.eu/ctis-public/view/2024-517264-27-00